EU clinical trial 2024-520413-53-00: A randomized, parallel-arm, double blind, placebo-controlled study to assess the efficacy of fampridine for patients with spinocerebellar ataxia SCA27B caused by a GAA expansion in the FGF14 gene.(TREAT-FGF14)
Protocol code: APHP240921
Sponsor: Assistance Publique Hopitaux De Paris (Hospital/Clinic/Other health care facility). Phase: Therapeutic confirmatory (Phase III). Countries: France (ongoing, recruiting).
Therapeutic area(s): Diseases [C] - Nervous System Diseases [C10]
Gender: Female, Male. Age: 18-64 years, 65+ years. Enrolment: 70.
Status: Ongoing, recruiting. Start date (EU): 2025-10-21. Decision date: 2025-08-01. Results received: No. Last updated: 2026-06-26.

Condition(s): Spinocerebellar ataxia
Product: FAMPRIDINE, Placebo 515

Primary endpoint: The primary endpoint is the proportion of patients showing an improvement of at least 0.5 point on the FARS-Functional Staging at week 12 as compared to baseline.
Endpoint(s): Improvement of at least 0.5 point on the FARS-Functional Staging at week 2, Variation in cerebellar syndrome assessed by the SARA at week 2 and week 12, Variation in cerebellar syndrome assessed by the mFARS scale at week 2 and week 12, Variation in cerebellar syndrome assessed by the CCFS score at week 2 and week 12, Variation in extracerebellar signs assessed by the INAS at week 12, Variation in walking ability assessed by the T25FW at week 2 and week 12, Variation in oculomotor signs assessed by the SODA at week 2 and week 12, Variation in oculomotor signs assessed by OMR at week 2 and week 12, Variation in daily frequency of diplopia assessed by the Numerical Diplopia Rating Scale (NDRS) at week 2 and week 12, Variation in daily living activities evaluated by the FARS–Activities of Daily Living at week 12, Quality of life evaluated by the PROM-ATAXIA and 36-Item Short Form Health Survey (SF-36) at week 12, Patient's impression evaluated by the Patient Global Impression of change (PGI-C) at week 2 and week 12, Clinician’s impression evaluated by the Clinician Global Impression of Change (CGI-C) at week 2 and week 12, oleTolerance assessed by clinical exam, blood analysis, and ECG at week 2 and week 12, as well as adverse events recordings, Clinical, neurological, and quality of life assessments at week 16, i.e. 4 weeks after treatment interruption

Source: https://euclinicaltrials.eu/ctis-public/view/2024-520413-53-00